EU clinical trial 2023-507470-40-00: A Double-Arm, Open Label, Phase III Study to Compare the Efficacy and Safety of SCENESSE® and Narrow-Band Ultraviolet B (NB-UVB) Light versus NB-UVB Light Alone in the Treatment of Vitiligo
Protocol code: CUV105
Sponsor: Clinuvel Inc. (Pharmaceutical company). Phase: Phase II and Phase III (Integrated). Countries: Italy (ended), France (ongoing, recruitment ended).
Therapeutic area(s): Diseases [C] - Skin and Connective Tissue Diseases [C17]
Gender: Female, Male. Age: 0-17 years, 18-64 years, 65+ years. Enrolment: 40.
Start date (EU): 2024-08-27. Decision date: 2024-04-18. Results received: No. Last updated: 2026-01-21.
Decision dates by country: IT: 2024-04-18, FR: 2024-04-23

Condition(s): Vitiligo
Product: SCENESSE 16 mg implant

Primary endpoint: Percentage of participants achieving re pigmentation in those treated with SCENESSE® and NB-UVB compared to NB-UVB alone.
Endpoint(s): Time to onset of repigmentation, Time to onset of repigmentation of face

Source: https://euclinicaltrials.eu/ctis-public/view/2023-507470-40-00